EU clinical trial 2024-517513-32-00: A Multicenter, Open-Label, Long-term, Extension Study to Evaluate the Safety and Tolerability of Dazodalibep in Participants with Sjögren’s Syndrome (SS)
Protocol code: 20230050
Sponsor: Amgen Inc. (Pharmaceutical company). Phase: Therapeutic confirmatory (Phase III). Countries: Slovenia (ongoing, recruiting), Hungary (ongoing, recruiting), Denmark (ended), Spain (ongoing, recruiting), Greece (ongoing, recruiting), Portugal (ongoing, recruiting), Germany (ongoing, recruiting), Poland (ongoing, recruiting), Belgium (ongoing, recruiting), France (ongoing, recruiting), Italy (ongoing, recruiting), Croatia (ongoing, recruitment ended).
Therapeutic area(s): Phenomena and Processes [G] - Immune System Phenomena [G13]; Phenomena and Processes [G] - Immune system processes [G12]; Diseases [C] - Immune System Diseases [C20]
Gender: Female, Male. Age: 18-64 years, 65+ years. Enrolment: 337.
Start date (EU): 2025-05-16. Decision date: 2025-04-29. Results received: No. Last updated: 2026-03-16.
Decision dates by country: HR: 2025-05-05, DK: 2025-04-29, FR: 2025-04-29, BE: 2025-04-30, DE: 2025-04-30, HU: 2025-04-29, PT: 2025-04-29, SI: 2025-04-29, PL: 2025-05-04, ES: 2025-04-29, GR: 2025-04-29, IT: 2025-05-05

Condition(s): Sjögren’s Syndrome
Product: Dazodalibep

Primary endpoint: Incidence of treatment-emergent adverse events, treatment-emergent serious adverse events, and adverse events of special interest (AESIs).
Endpoint(s): 1.Development of positive anti-drug antibodies (ADAs) during the study., 2. Plasma concentration of dazodalibep.

Source: https://euclinicaltrials.eu/ctis-public/view/2024-517513-32-00